EU clinical trial 2024-517040-65-02: A 6-Month, Randomized, Double-Blind Study to Evaluate the Effect of Dapagliflozin on EChOcardiographic Measures of CarDiac StructurE and Function in Patients with Chronic Kidney Disease (DECODE-CKD)
Sponsor: Gentofte Hospital (Hospital/Clinic/Other health care facility). Phase: Phase I and Phase II (Integrated)- Other. Countries: Denmark (authorised, recruitment pending).
Therapeutic area(s): Diseases [C] - Cardiovascular Diseases [C14]
Gender: Female, Male. Age: 18-64 years, 65+ years. Enrolment: 260.
Status: Authorised, recruitment pending. Decision date: 2024-10-15. Results received: No. Last updated: 2025-01-29.

Condition(s): Chronic kidney disease
Product: The placebo will be identical in apperance and contains the following ingredients: FDA/E172 Red Iron Oxide, Titanium dioxide, Hydromellose., DAPAGLIFLOZIN

Primary endpoint: Change in LV mass index assessed by echocardiography at 6 months
Endpoint(s): Change in LV ejection fraction at 6 months, Change in global longitudinal strain at 6 months, Change in LV end-diastolic volume at 6 months, Change in LV end-systolic volume at 6 months, Change in left atrial volume index at 6 months, Change in creatinine/eGFR at 6 months, Change in UACR at 6 months, Change in haemoglobin at 6 months, Change in proBNP at 6 months, Change in Troponin at 6 months, Change in LV mass at 6 months

Source: https://euclinicaltrials.eu/ctis-public/view/2024-517040-65-02